EU clinical trial 2026-525808-94-00: EXUROC Bladder Target - A phase Ib/ll study to determine the safety, tolerability, and efficacy of LP-184 treatment in patients with advanced/metastatic urothelial carcinoma
Protocol code: EXUROC Bladder Targe
Sponsor: Region Hovedstaden (Hospital/Clinic/Other health care facility). Phase: Phase I and Phase II (Integrated)- Other. Countries: Denmark (authorised, recruitment pending).
Therapeutic area(s): Diseases [C] - Neoplasms [C04]
Gender: Female, Male. Age: 18-64 years, 65+ years. Enrolment: 39.
Status: Authorised, recruitment pending. Decision date: 2026-07-10. Results received: No. Last updated: 2026-07-10.

Condition(s): Oncology
Product: LP-184

Primary endpoint: Phase Ib: Dose-Limiting Toxicity (DLT) according to CTCAE version 5.0., Phase Ib: Recommended Phase 2 Dose (RP2D)., Phase ll: Objective Response Rate (ORR) according to RECIST criteria version 1.1.
Endpoint(s): Progression-Free Survival (PFS), Overall Survival (OS), Duration of Response (DoR)

Source: https://euclinicaltrials.eu/ctis-public/view/2026-525808-94-00